EU clinical trial 2024-513863-21-00: A Study to Learn if the Study Medicines Called Itraconazole and Cyclosporine Change How the Body Processes the Other Study Medicine Called Danuglipron in Healthy Adults
Protocol code: C3421063
Sponsor: Pfizer Inc. (Pharmaceutical company). Phase: Human Pharmacology (Phase I)- Other. Countries: Belgium (ended).
Therapeutic area(s): Diseases [C] - Nutritional and Metabolic Diseases [C18]
Gender: Female, Male. Age: 18-64 years, 65+ years. Enrolment: 16.
Status: Ended. End date (EU): 2024-09-30. End date: 2025-03-10. Decision date: 2024-07-23. Results received: No. Last updated: 2025-06-24.

Condition(s): Type 2 Diabetes Mellitus, Obesity, Overweight management

Source: https://euclinicaltrials.eu/ctis-public/view/2024-513863-21-00